EU clinical trial 2025-523033-26-00: Boosting osimertinib Blood Brain Barrier penetration in patients with epidermal growth factor receptor mutated non-small cell lung cancer (OSIBBBOOST)
Protocol code: OSIBBBOOST
Sponsor: Academisch Ziekenhuis Maastricht (Hospital/Clinic/Other health care facility). Phase: Therapeutic exploratory (Phase II). Countries: Netherlands (authorised, recruitment pending).
Therapeutic area(s): Diseases [C] - Respiratory Tract Diseases [C08]; Diseases [C] - Neoplasms [C04]
Gender: Female, Male. Age: 18-64 years, 65+ years. Enrolment: 14.
Status: Authorised, recruitment pending. Decision date: 2026-03-19. Results received: No. Last updated: 2026-03-19.

Condition(s): Patients with EGFR-mutated metastatic NSCLC, without CNS metastases on brain MRI and without the ABCG2 34G>A SNP, treated with osimertinib as part of regular care are eligible for inclusion. Participants have at least radiologically proven stable disease (SD) or better on regular care osimertinib therapy.
Product: TAGRISSO 80 mg film-coated tablets, ADENURIC 80 mg film-coated tablets

Primary endpoint: Osimertinib concentration in CSF and plasma before and after combination with febuxostat
Endpoint(s): Osimertinib concentration in CSF before and after combination with febuxostat, Osimertinib plasma trough concentration before and after addition of febuxostat, AZ5104 and AZ7550 plasma trough concentration before and after combination with febuxostat, AZ5104 and AZ7550 CSF concentration before and after combination with febuxostat, Adverse events according to CTCAE v5.0 criteria, ABCB1 and ABCG2 genotype status, and osimertinib, AZ5104 and AZ7550 CNS concentrations, AEs and osimertinib, AZ5104 and AZ7550 concentrations in blood and CSF

Source: https://euclinicaltrials.eu/ctis-public/view/2025-523033-26-00